EU clinical trial 2023-510452-23-00: An Early Phase Study to Investigate the Safety and Efficacy of HS135 in Adult Patients With Pulmonary Arterial Hypertension (PAH)
Protocol code: HS135-002
Sponsor: 35Pharma Inc. (Pharmaceutical company). Phase: Human Pharmacology (Phase I)- Other. Countries: Hungary (ended), Poland (ended), Germany (ended).
Therapeutic area(s): Diseases [C] - Cardiovascular Diseases [C14]
Gender: Female, Male. Age: 18-64 years, 65+ years. Enrolment: 16.
Status: Ended. Start date (EU): 2024-10-29. End date (EU): 2025-04-29. End date: 2025-04-30. Decision date: 2024-06-24. Results received: No. Last updated: 2024-10-02.
Decision dates by country: DE: 2024-10-02, PL: 2024-07-01, HU: 2024-10-01

Condition(s): Pulmonary arterial hypertension

Source: https://euclinicaltrials.eu/ctis-public/view/2023-510452-23-00